EU clinical trial 2024-511172-33-00: A Multicenter, Long-term, Follow-up Study to Investigate the Safety and Durability of Response Following Dosing of an Adeno-associated Viral Vector (FLT201) in Subjects with Gaucher Disease (GALILEO-2)
Protocol code: FLT201-02
Sponsor: Spur Therapeutics Limited (Pharmaceutical company). Phase: Phase I and Phase II (Integrated)- Other. Countries: Spain (ongoing, recruitment ended).
Therapeutic area(s): Diseases [C] - Congenital, Hereditary, and Neonatal Diseases and Abnormalities [C16]
Gender: Female, Male. Age: 18-64 years, 65+ years. Enrolment: 1.
Status: Ongoing, recruitment ended. Start date (EU): 2024-05-10. Decision date: 2024-04-29. Results received: No. Last updated: 2026-05-05.

Condition(s): Gaucher Disease Type 1
Product: FLT201

Primary endpoint: Incidence of treatment-emergent adverse events (TEAEs) (including DLTs)
Endpoint(s): 1. Incidence of AEs, SAEs, and changes from baseline in vital signs, 12-lead ECG, physical examination, and laboratory assessments., 2. Change from baseline in GCase activity (Dried Blood Spot [DBS]), plasma GCase activity and relative concentration, and leukocyte GCase activity over time., 3. Change from baseline in lyso-Gb1 concentration., 4. Change from baseline in hemoglobin, platelet count, spleen volume as measured by MRI, and liver volume as measured by MRI., 5. Change from baseline in GCase antibody levels., 6. Time to clearance of vector genomes in plasma and semen until three consecutive negative samples, where applicable (this may be completed in the preceding treatment trial and, if so, will not be followed-up within this trial.)

Source: https://euclinicaltrials.eu/ctis-public/view/2024-511172-33-00